EU clinical trial 2024-515698-85-00: A Randomized, Double-Blind, Phase 3 Trial of Adagrasib plus Pembrolizumab plus Chemotherapy vs. Placebo plus Pembrolizumab plus Chemotherapy in Participants with previously Untreated, Locally Advanced or Metastatic Non-squamous Non-small Cell Lung Cancer with KRAS G12C Mutation (KRYSTAL-4)
Protocol code: CA239-0004
Sponsor: Bristol-Myers Squibb Services Unlimited Company (Pharmaceutical company). Phase: Therapeutic confirmatory (Phase III). Countries: Hungary (ongoing, recruiting), Romania (ongoing, recruiting), Netherlands (ongoing, recruiting), Austria (ongoing, recruiting), Croatia (ongoing, recruiting), France (ongoing, recruiting), Ireland (ongoing, recruiting), Bulgaria (ongoing, recruiting), Germany (ongoing, recruiting), Poland (ongoing, recruiting), Greece (ongoing, recruiting), Italy (ongoing, recruiting), Portugal (ongoing, recruiting), Spain (ongoing, recruiting), Belgium (ongoing, recruiting).
Therapeutic area(s): Diseases [C] - Neoplasms [C04]
Gender: Female, Male. Age: 18-64 years, 65+ years. Enrolment: 257.
Status: Ongoing, recruiting. Start date (EU): 2025-06-12. Decision date: 2025-06-03. Results received: No. Last updated: 2026-06-09.
Decision dates by country: BG: 2025-06-06, FR: 2025-06-13, HU: 2025-06-10, DE: 2025-06-04, BE: 2025-06-03, ES: 2025-06-10, PT: 2025-06-03, AT: 2025-06-05, IT: 2025-06-05, PL: 2025-06-23, IE: 2025-06-06, RO: 2025-06-10, NL: 2025-06-06, HR: 2025-06-09, GR: 2025-06-26

Condition(s): Locally Advanced or Metastatic Non-small Cell Lung Cancer
Product: PEMETREXED, PALONOSETRON, Adagrasib, PEMBROLIZUMAB, CARBOPLATIN, tablets, CISPLATIN

Primary endpoint: To compare PFS of adagrasib + pembrolizumab + chemotherapy to placebo + pembrolizumab + chemotherapy., To compare OS of adagrasib + pembrolizumab + chemotherapy to placebo + pembrolizumab + chemotherapy.
Endpoint(s): PFS per RECIST v1.1 according to BICR.

Source: https://euclinicaltrials.eu/ctis-public/view/2024-515698-85-00